EU clinical trial 2024-512696-12-00: Asciminib as single agent or in combination with nilotinib in the 1st-line treatment of BCR-ABL1+ Chronic Myeloid Leukemia: a GIMEMA-GELMC phase II study. CML1624
Protocol code: CML1624
Sponsor: Fondazione Gimema Franco Mandelli Onlus, Grupo Espanol De Leucemia Mieloide Cronica (GELMC) (Patient organisation/association). Phase: Therapeutic exploratory (Phase II). Countries: Spain (ongoing, recruitment ended), Italy (ongoing, recruitment ended).
Therapeutic area(s): Diseases [C] - Hemic and Lymphatic Diseases [C15]
Gender: Female, Male. Age: 18-64 years, 65+ years. Enrolment: 160.
Status: Ongoing, recruitment ended. Start date (EU): 2025-06-24. Decision date: 2025-04-22. Results received: No. Last updated: 2026-02-27.
Decision dates by country: ES: 2025-04-22, IT: 2025-04-23

Condition(s): BCR-ABL1+ Chronic Myeloid Leukemia
Product: Tasigna 150 mg hard capsules, Scemblix 40 mg film-coated tablets

Primary endpoint: The primary endpoint is the rate of deep molecular response (MR4) at 2 years; patients with not evaluable molecular analysis may repeat a QPCR analysis in 1 month (25 months from day 1)
Endpoint(s): The rate of sustained MR4 or MR4.5 at 4 years (TFR eligibility) and the proportion of patients free from relapse (BCR::ABL1 transcript < 0.1%) 12 months after treatment discontinuation, The rate of major molecular response (MR3) at and by 1, 2, 3, 6, 12, 18 and 24 months, and the rate of MR4 and MR4.5 at and by 1, 2, 3, 4 years, The median time to response (MR3, MR4, MR4.5) and the relationship between the time to response (response at milestones) and the TFR eligibility at 4 years and the TFR rate 12 months after discontinuation, Outcome measures at 2 and 5 years: overall survival (OS), survival without leukemia-related death, progression-free survival (PFS), Outcome measures at 5 years according to baseline prognostic factors (Sokal and ELTS score, CCA in Ph+ cells, BCR::ABL transcript type, and according to the early response (BCR::ABL transcript level at 3 and 6 months), Incidence and VAF of treatment emergent BCR::ABL1 mutations, Incidence and VAF of BL and treatment emergent cancer related somatic mutations and relationship with treatment efficacy, including treatment-free remission and outcome, Incidence of hematologic and non-hematologic adverse events, Mean HRQoL scores trajectories by the EORTC QLQ-C30 and QLQ-CML24 questionnaires according to treatment arm

Source: https://euclinicaltrials.eu/ctis-public/view/2024-512696-12-00